EU clinical trial 2023-508542-18-00: The SANT-study - A randomized controlled clinical trial of Streptococcus group A-negative acute tonsillitis in primary health care - a comparison of phenoxymethylpenicillin and no antibiotic treatment
Protocol code: SANT-trial
Sponsor: Region Joenkoepings Laen (Hospital/Clinic/Other health care facility). Phase: Therapeutic use (Phase IV). Countries: Sweden (ongoing, recruiting).
Therapeutic area(s): Diseases [C] - Respiratory Tract Diseases [C08]
Gender: Female, Male. Age: 0-17 years, 18-64 years, 65+ years. Enrolment: 390.
Status: Ongoing, recruiting. Start date (EU): 2019-09-02. Decision date: 2023-11-01. Results received: No. Last updated: 2026-06-16.

Condition(s): Tonsilitis
Product: PHENOXYMETHYLPENICILLIN

Primary endpoint: Differences in number of days from inclusion to resolution of symptoms. Student t-test will be used to determine differences in number of days from inclusion to resolution of all symptoms between study group 1 and study group 2.

Source: https://euclinicaltrials.eu/ctis-public/view/2023-508542-18-00